EU clinical trial 2023-506202-40-01: Effectiveness of methylphenidate in children and adolescents with KBG syndrome: An N-of-1 series
Protocol code: 113883
Sponsor: Stichting Radboud University Medical Center (Hospital/Clinic/Other health care facility). Phase: Therapeutic use (Phase IV). Countries: Netherlands (ongoing, recruiting).
Therapeutic area(s): Psychiatry and Psychology [F] - Behavioral Disciplines and Activities [F04]
Gender: Female, Male. Age: 0-17 years, 18-64 years. Enrolment: 15.
Status: Ongoing, recruiting. Start date (EU): 2024-10-01. Decision date: 2024-06-27. Results received: No. Last updated: 2024-10-29.

Condition(s): KBG syndrome
Product: Methylphenidate Hydrochloride 5 mg Tablets, Microcrystalline cellulose, Methylphenidate Hydrochloride 10 mg Tablets

Primary endpoint: Strenghts and Difficulties Questionnaire, ADHD subscale
Endpoint(s): SDQ, emotional problems subscale, Dutch shortened version of the Emotion Dysregulation Inventory (EDI) reactivity index, Goal Attainment Scoring (GAS), Personal Questionnaire (PQ), Adverse Effects checklist for methylphenidate, McMaster Family assessment device (FAD), subscale General Functioning, Previous IQ test results, ADOS-2

Source: https://euclinicaltrials.eu/ctis-public/view/2023-506202-40-01